EU clinical trial 2025-522455-26-00: A Phase 1b/2a Open-Label Dose-Finding Followed by Randomized, Double-Blind, Placebo-Controlled Expansion Study to Evaluate the Safety, Tolerability, and Preliminary Efficacy of TGD001 in Patients with Acute Ischemic Stroke
Protocol code: TG1-CL-201
Sponsor: TargED Biopharmaceuticals B.V. (Pharmaceutical company). Phase: Phase I and Phase II (Integrated)- Other. Countries: Poland (authorised, recruiting), Germany (ongoing, recruiting), Spain (authorised, recruiting).
Therapeutic area(s): Diseases [C] - Nervous System Diseases [C10]
Gender: Female, Male. Age: 18-64 years, 65+ years. Enrolment: 80.
Start date (EU): 2025-12-17. Decision date: 2025-10-31. Results received: No. Last updated: 2026-05-13.
Decision dates by country: PL: 2025-10-31, ES: 2025-10-31, DE: 2025-11-03

Condition(s): Acute Ischemic Stroke
Product: SODIUM CHLORIDE SOLUTION 0.9%

Primary endpoint: Symptomatic intracranial hemorrhage (sICH), Treatment emergent adverse events (TEAEs)

Source: https://euclinicaltrials.eu/ctis-public/view/2025-522455-26-00